EU clinical trial 2023-505750-17-00: A Long-term Follow-Up Study to Evaluate the Safety and Efficacy of RGX-314 Following Subretinal Administration in Participants with Neovascular Age-related Macular Degeneration and Fellow Eye Treatment Substudy
Protocol code: M23-422
Sponsor: AbbVie Deutschland GmbH & Co. KG (Pharmaceutical company). Phase: Therapeutic exploratory (Phase II). Countries: Italy (authorised, recruitment pending), Hungary (authorised, recruitment pending), France (authorised, recruitment pending), Spain (authorised, recruitment pending), Germany (authorised, recruitment pending).
Therapeutic area(s): Diseases [C] - Eye Diseases [C11]
Gender: Female, Male. Age: 18-64 years, 65+ years. Enrolment: 84.
Status: Authorised, recruitment pending. Decision date: 2025-07-14. Results received: No. Last updated: 2026-06-04.
Decision dates by country: FR: 2025-07-16, HU: 2025-07-18, IT: 2025-07-14, ES: 2025-07-16, DE: 2025-07-17

Condition(s): Neovascular age-related macular degeneration
Product: Surabgene Lomparvovec (ABBV-RGX-314), Surabgene Lomparvovec (ABBV-RGX-314)

Primary endpoint: Incidence of ocular adverse events (AEs) and any serious adverse events (SAEs)
Endpoint(s): Incidence of non-ocular AEs and any adverse events of special interest (AESIs), Mean change from baseline (ie, prior to ABBV-RGX-314 administration in the parent study) in BCVA, Proportion of participants losing letters in BCVA compared with baseline (ie, prior to ABBV-RGX 314 administration in the parent study) in the study eye at assessed timepoints, Mean change from baseline (ie, prior to ABBV-RGX-314 administration in the parent study) in CRT as measured by SD-OCT in the study eye at assessed timepoints, Mean supplemental anti-VEGF injection annualized rate through years 2, 3, 4, and 5 based on ongoing chart review in the study eye, Mean supplemental anti-VEGF injection annualized rate in years 2, 3, 4, and 5 based on ongoing chart review in the study eye, Mean number of supplemental anti-VEGF injections through years 2, 3, 4, and 5 based on ongoing chart review in the study eye, Mean number of supplemental anti-VEGF injections in years 2, 3, 4, and 5 based on ongoing chart review in the study eye, Mean number of retina specialist visits attended for nAMD through years 2, 3, 4, and 5 based on ongoing chart review, Mean number of retina specialist visits attended for nAMD in years 2, 3, 4, and 5 based on ongoing chart review

Source: https://euclinicaltrials.eu/ctis-public/view/2023-505750-17-00